EU clinical trial 2025-522868-32-00: Changes in plaque characteristics after short-term statin therapy assessed with coronary CT
Protocol code: INTENSE
Sponsor: Semmelweis University (Educational Institution). Phase: Phase II and Phase III (Integrated). Countries: Hungary (authorised, recruitment pending).
Therapeutic area(s): Diseases [C] - Cardiovascular Diseases [C14]
Gender: Female, Male. Age: 18-64 years, 65+ years. Enrolment: 140.
Status: Authorised, recruitment pending. Decision date: 2025-09-26. Results received: No. Last updated: 2025-09-26.

Condition(s): Coronary Artery Disease, Cardiology, Statin Therapy, Coronary Computed Tomography Angiography, Stable chest pain
Product: Tabletta placebo 0,2 g fehér, laktózmentes (4x) tartalmú kapszula, Xeter 10 mg filmtabletta

Primary endpoint: Non-calcified plaque volume at 3 months follow-up (expressed as mm3).
Endpoint(s): Plaque composition measured during the 3-month visit: each component expressed in mm³ – low attenuation: −100 to 30 HU; non-calcified: 30 to 350 HU; calcified: >350 HU., Major adverse events (death, cardiovascular death, fatal and nonfatal myocardial infarction, fatal and nonfatal stroke/TIA, unstable angina, hospitalization)), Minor adverse events (muscle pain, constipation, abdominal pain or meteorismus, nausea, headache, vertigo, fatigue, skin rash, pruritus), Laboratory parameters (total cholesterol, low-density lipoprotein (LDL) cholesterol, high-density lipoprotein (HDL) cholesterol, triglycerides, LP(a), apoA1, apoB, hs-CRP, ferritin and hemoglobin A1c., Total plaque volume (mm3) during the 3-month follow up, Low-attenuation non-calcified plaque volume during the 24-month follow-up period (mm³), CT-based Fractional Flow Reserve (FFR-CT) during the 3 months follow-up, CT-based Fractional Flow Reserve (FFR-CT) during the 24 months follow-up, Plaque composition measured during the 24-month visit: each component expressed in mm³ – low attenuation: −100 to 30 HU; non-calcified: 30 to 350 HU; calcified: >350 HU., Low-attenuation non-calcified plaque volume during the 3-month follow-up period (expressed in mm³), Total plaque volume (mm3) during the 24-month follow up, Visual presence of high risk plaque features during the 3-month follow up: low attenuation plaque, positive remodeling, napkin-ring sign, spotty calcification, minimal luminal area or plaque burden ≥70%, Radiomic features during the 3-month follow up, Radiomic features during the 24-month follow-up, Non-calcified plaque volume at 24 months follow-up (expressed as mm3)., Visual presence of high risk plaque features during the 24-month follow up: low attenuation plaque, positive remodeling, napkin-ring sign, spotty calcification, minimal luminal area or plaque burden ≥70%

Source: https://euclinicaltrials.eu/ctis-public/view/2025-522868-32-00